EU clinical trial 2023-503714-77-00: A Phase 2 Trial of Combination Therapies with Adagrasib in Patients with Advanced Non-Small Cell Lung Cancer with KRAS G12C Mutation
Protocol code: 849-017
Sponsor: Mirati Therapeutics Inc. (Pharmaceutical company). Phase: Therapeutic exploratory (Phase II). Countries: Hungary (ongoing, recruitment ended), Poland (ended), Spain (ongoing, recruitment ended), France (ongoing, recruitment ended), Italy (ongoing, recruitment ended), Greece (ended).
Therapeutic area(s): Diseases [C] - Neoplasms [C04]
Gender: Female, Male. Age: 18-64 years, 65+ years. Enrolment: 101.
Start date (EU): 2024-10-01. Decision date: 2023-09-18. Results received: No. Last updated: 2026-07-01.
Decision dates by country: GR: 2023-09-20, PL: 2023-09-25, ES: 2023-09-18, HU: 2023-09-25, FR: 2023-09-22, IT: 2023-09-22

Condition(s): Advanced Non-Small Cell Lung Cancer
Product: PEMBROLIZUMAB, PEMETREXED, Adagrasib, PALONOSETRON, CARBOPLATIN, CISPLATIN, PEMETREXED, DEXAMETHASONE, PEMETREXED, PEMETREXED

Primary endpoint: Cohorts A and E: Objective response rate (ORR), as defined by Response Evaluation Criteria in Solid Tumors Version 1.1 (RECIST v1.1)., Cohort C: PFS at 6 months (PFS6)
Endpoint(s): Cohorts C and E: Dose-limiting toxicities (DLTs) during safety lead-in (SLI), Safety characterized by type, incidence, severity, timing, seriousness, and relationship to study treatment of adverse events (AEs) and laboratory abnormalities, Summary statistics of adagrasib concentrations, Secondary efficacy endpoints: Duration of response (DOR)

Source: https://euclinicaltrials.eu/ctis-public/view/2023-503714-77-00